EU clinical trial 2024-511851-16-00: A phase 1 study to evaluate the dose, safety and tolerability of a radionuclide therapy (Radspherin®) in patients with platinum sensitive recurrent epithelial ovarian, fallopian tube or primary peritoneal carcinoma with peritoneal carcinomatosis following complete surgical resection
Sponsor: Oncoinvent ASA (Pharmaceutical company). Phase: Human Pharmacology (Phase I)- First administration to humans. Countries: Spain (ended), Norway (ended), Belgium (ended).
Therapeutic area(s): Diseases [C] - Neoplasms [C04]
Gender: Female. Age: 18-64 years, 65+ years. Enrolment: 40.
Status: Ended. Start date (EU): 2024-09-20. End date (EU): 2025-09-08. Decision date: 2024-09-20. Results received: No. Last updated: 2025-05-09.
Decision dates by country: BE: 2024-09-20, ES: 2024-09-20, NO: 2024-09-20

Condition(s): Platinum Sensitive Recurrent Epithelial Ovarian, Fallopian Tube or Primary Peritoneal Carcinoma With Peritoneal Carcinomatosis

Source: https://euclinicaltrials.eu/ctis-public/view/2024-511851-16-00